EU clinical trial 2024-514532-24-00: A study in people with advanced cancer to test whether the amount of BI 907828 in the blood is influenced by taking an OATP inhibitor or a CYP3 inhibitor
Protocol code: 1403-0004
Sponsor: Boehringer Ingelheim International GmbH (Pharmaceutical company). Phase: Human Pharmacology (Phase I)- Other. Countries: Belgium (ended), Spain (ended).
Therapeutic area(s): Diseases [C] - Neoplasms [C04]
Gender: Female, Male. Age: 18-64 years, 65+ years. Enrolment: 33.
Status: Ended. Start date (EU): 2022-06-23. End date (EU): 2025-04-29. Decision date: 2024-09-24. Results received: No. Last updated: 2024-12-06.
Decision dates by country: BE: 2024-09-26, ES: 2024-09-24

Condition(s): Solid cancer tumors

Source: https://euclinicaltrials.eu/ctis-public/view/2024-514532-24-00